EU clinical trial 2024-517856-36-00: A Phase III Prospective Double Blind Placebo Controlled Randomized Study of Adjuvant MEDI4736 in Completely Resected Non-Small Cell Lung Cancer (BR31)
Protocol code: BR31
Sponsor: NVALT-studies Stichting, Intergroupe Francophone De Cancerologie Thoracique, Fundacion GECP, Queen's University, Clinipace Global Limited (Patient organisation/association, Patient organisation/association, Patient organisation/association, Educational Institution, Pharmaceutical company). Phase: Therapeutic confirmatory (Phase III). Countries: Bulgaria (ended), Spain (ended), Romania (ended), Netherlands (ended), France (ended), Poland (ended), Hungary (ended), Italy (ended).
Therapeutic area(s): Diseases [C] - Neoplasms [C04]
Gender: Female, Male. Age: 18-64 years, 65+ years. Enrolment: 655.
Status: Ended. Start date (EU): 2015-03-09. End date (EU): 2025-03-27. End date: 2025-04-12. Decision date: 2024-11-11. Results received: Yes. Last updated: 2024-12-03.
Decision dates by country: BG: 2024-12-03, FR: 2024-11-20, HU: 2024-11-12, IT: 2024-11-18, RO: 2024-11-27, ES: 2024-11-12, NL: 2024-11-11, PL: 2024-11-14

Condition(s): Completely resected primary stage IB (≥ 4cm), II and IIIA non-small cell lung cancer patients
Product: MEDI4736 Placebo, DURVALUMAB

Primary endpoint: Disease free survival (DFS) for patients with NSCLC that is PD-L1 expression TC ≥ 25% and EGFR-/ALK-.
Endpoint(s): DFS in the remaining 5 patient sub-populations defined by PD-L1 expression levels and EGFR/ALK status., Overall survival (OS) for patients in the six patient sub-populations defined by PD-L1 expression levels and EGFR/ALK status., Lung cancer specific survival for patients in the six patient sub-populations defined by PD-L1 expression levels and EGFR/ALK status., Adverse effects and tolerability of MEDI4736., Quality of life in the six patient sub-populations defined by PD-L1 expression levels and EGFR/ALK status., Survival benefits participants judge necessary to make adjuvant immunotherapy worthwhile., Economic evaluation (cost effectiveness and cost utility)., Evaluation of predictive/prognostic significance of PD-L1 expression., Evaluation of changes in plasma/serum cytokines and other blood and tissue based biomarkers after treatment with MEDI4736 and at disease event., Exploratory pharmacogenomic assays (baseline only).

Source: https://euclinicaltrials.eu/ctis-public/view/2024-517856-36-00